EU clinical trial 2024-515773-99-00: Phase 2, Multicenter, Double-blind, Extension Study to Evaluate the Effects of Sotatercept for the Treatment of Combined Postcapillary and Precapillary Pulmonary Hypertension (Cpc-PH) due to Heart Failure with Preserved Ejection Fraction (HFpEF)
Protocol code: MK-7962-023
Sponsor: Merck Sharp & Dohme LLC (Pharmaceutical company). Phase: Therapeutic exploratory (Phase II). Countries: Italy (ongoing, recruitment ended), Germany (ongoing, recruitment ended), France (ongoing, recruitment ended), Sweden (ongoing, recruitment ended), Belgium (ongoing, recruitment ended), Poland (ongoing, recruitment ended), Spain (ongoing, recruitment ended).
Therapeutic area(s): Diseases [C] - Cardiovascular Diseases [C14]
Gender: Female, Male. Age: 18-64 years, 65+ years. Enrolment: 63.
Status: Ongoing, recruitment ended. Start date (EU): 2025-05-26. Decision date: 2025-04-28. Results received: No. Last updated: 2025-11-20.
Decision dates by country: SE: 2025-04-29, ES: 2025-04-30, IT: 2025-04-29, FR: 2025-04-28, BE: 2025-04-29, DE: 2025-04-29, PL: 2025-05-04

Condition(s): Pulmonary Hypertension
Product: SOTATERCEPT, SOTATERCEPT, sotatercept, sotatercept

Primary endpoint: Number of Participants Who Experience an Adverse Event (AE), Number of Participants Who Discontinue Study Treatment Due to an AE
Endpoint(s): Change From Baseline in Pulmonary Vascular Resistance (PVR) at Week 48, Change From Baseline in the 6-Minute Walk Distance (6MWD) at Week 48, Change From Baseline in the 6MWD at Week 126, Change From Baseline in the 6MWD at Week 174, Change From Baseline in New York Heart Association Functional Class (NYHA FC) at Week 48, Change From Baseline in NYHA FC at Week 126, Change From Baseline in NYHA FC at Week 174, Change From Baseline in N-terminal Pro-hormone Brain Natriuretic Peptide (NT-proBNP) at Week 48, Change From Baseline in NT-proBNP at Week 126, Change From Baseline in NT-proBNP at Week 174, Change From Week 24 in PVR at Week 48, Change From Week 24 in 6MWD at Week 48, Change From Week 24 in NYHA FC at Week 48

Source: https://euclinicaltrials.eu/ctis-public/view/2024-515773-99-00